EU clinical trial 2023-506759-51-00: A study of STX-721/PFL-721 in participants with non-small cell lung cancer with certain mutations
Protocol code: PFL721CI101
Sponsor: Pierre Fabre Medicament (Pharmaceutical company). Phase: Phase I and Phase II (Integrated)- First administration to humans. Countries: France (ongoing, recruiting), Spain (ongoing, recruiting), Netherlands (ongoing, recruiting), Germany (ongoing, recruiting).
Therapeutic area(s): Diseases [C] - Neoplasms [C04]
Gender: Female, Male. Age: 18-64 years, 65+ years. Enrolment: 185.
Status: Ongoing, recruiting. Start date (EU): 2024-03-29. Decision date: 2024-02-19. Results received: No. Last updated: 2026-07-07.
Decision dates by country: NL: 2024-04-22, FR: 2024-02-26, DE: 2024-04-24, ES: 2024-04-24

Condition(s): Locally Advanced or Metastatic Non-Small Cell Lung Cancer

Source: https://euclinicaltrials.eu/ctis-public/view/2023-506759-51-00